EU clinical trial 2023-506614-40-00: A Phase 4, Multicenter, Randomized, Double-blind, Parallel Group, Placebo-controlled Study to Evaluate the Effect of Benralizumab on Structural and Lung Function Changes in Severe Eosinophilic Asthmatics (CHINOOK)
Protocol code: D3250C00059
Sponsor: Astrazeneca AB (Pharmaceutical company). Phase: Therapeutic use (Phase IV). Countries: Sweden (ongoing, recruitment ended), Denmark (ongoing, recruitment ended).
Therapeutic area(s): Diseases [C] - Respiratory Tract Diseases [C08]
Gender: Female, Male. Age: 18-64 years, 65+ years. Enrolment: 27.
Status: Ongoing, recruitment ended. Start date (EU): 2019-11-11. Decision date: 2024-03-14. Results received: No. Last updated: 2026-06-30.
Decision dates by country: DK: 2024-03-14, SE: 2024-03-15

Condition(s): Severe eosinophilic asthma
Product: Placebo for benralizumab for clinical trials is a sterile liquid solution presented in an accessorized prefilled syringe (apfs) for subcutaneous injection., Fasenra 30 mg solution for injection in pre-filled syringe

Primary endpoint: The change, expressed as a percentage from baseline to end of treatment (EOT) in eosinophil numbers, expressed as number/mm2 in submucosa., The change, expressed as a percentage, from baseline to EOT in airway WA% as the overall median for airway generations 3 and 4 combined. Supportive measure: Change, expressed as a percentage, from baseline to EOT in airway lumen area (LA), airway wall area (WA) and airway wall thickness (WT).

Source: https://euclinicaltrials.eu/ctis-public/view/2023-506614-40-00